EU clinical trial 2023-504504-28-00: The Direct Oral Anticoagulation versus Vitamin K Antagonist after Cardiac Surgery (DANCE) Trial
Protocol code: 2020.12.18
Sponsor: Hamilton Health Sciences Corporation (Hospital/Clinic/Other health care facility). Phase: Therapeutic confirmatory (Phase III). Countries: Germany (ongoing, recruiting).
Therapeutic area(s): Diseases [C] - Cardiovascular Diseases [C14]
Gender: Female, Male. Age: 18-64 years, 65+ years. Enrolment: 1000.
Status: Ongoing, recruiting. Start date (EU): 2024-10-25. Decision date: 2023-11-02. Results received: No. Last updated: 2023-12-22.

Condition(s): Patients with atrial fibrillation requiring anticoagulation.
Product: EDOXABAN, APIXABAN, DABIGATRAN, DABIGATRAN, PHENPROCOUMON, WARFARIN, WARFARIN, RIVAROXABAN, RIVAROXABAN, WARFARIN, EDOXABAN, PHENPROCOUMON, APIXABAN

Primary endpoint: Major bleeding at 30 days, defined as bleeding that results in death and/or symptomatic bleeding in a critical area or organ, bleeding into a surgical site requiring reoperation, bleeding leading to hospitalization (including presentation to an acute care facility without overnight stay) and/or bleeding that causes a drop in the hemoglobin level of 20g/L or more, or that which requires the transfusion of ≥2 units of packed red blood cells or whole blood
Endpoint(s): Composite of stroke and non-central nervous system systemic arterial embolism at 30 and 90 days. This is intended to be confirmatory as high quality evidence has demonstrated DOACs to be superior to VKAs for thromboembolic protection., Major bleeding at 90 days; pleural effusion requiring drainage, pericardial effusion requiring drainage, systemic arterial embolism, ischemic stroke, deep vein thrombosis, pulmonary embolism, all-cause mortality, length of postoperative hospital stay at 30 and 90 days; all-cause mortality at 6 months., Minor bleeding, all bleeding, myocardial infarction, valve thrombosis, hemorrhagic stroke, all stroke, all arterial thrombosis/thromboembolism (ischemic stroke, systemic arterial embolism, myocardial infarction, valve thrombosis), quality of life measured by the EQ-5D-5L questionnaire, patient satisfaction with their anticoagulant treatment as assessed by the Perception of Anticoagulant Treatment Questionnaire (PACT-Q) and aggregate costs for both groups at 30 and 90 days.

Source: https://euclinicaltrials.eu/ctis-public/view/2023-504504-28-00